EU clinical trial 2023-503545-67-00: A Multicenter, Open-Label, Study to Evaluate the Long-term Safety of Ecopipam Tablets in Children, Adolescents and Adults with Tourette’s Disorder
Protocol code: EBS-101-TD-391
Sponsor: Emalex Biosciences Inc. (Pharmaceutical company). Phase: Therapeutic confirmatory (Phase III). Countries: Spain (ongoing, recruitment ended), Germany (ongoing, recruitment ended), France (ongoing, recruitment ended), Denmark (ended), Italy (ongoing, recruitment ended), Bulgaria (ongoing, recruitment ended), Hungary (ongoing, recruitment ended), Poland (ongoing, recruitment ended).
Therapeutic area(s): Diseases [C] - Nervous System Diseases [C10]
Gender: Female, Male. Age: 0-17 years, 18-64 years, 65+ years. Enrolment: 38.
Start date (EU): 2024-04-30. Decision date: 2023-07-31. Results received: No. Last updated: 2026-05-05.
Decision dates by country: DK: 2023-08-01, FR: 2023-08-07, BG: 2023-08-07, PL: 2023-08-07, IT: 2023-08-04, ES: 2023-07-31, DE: 2023-08-02, HU: 2023-08-04

Condition(s): Tourette's Disorder
Product: Ecopipam 11.2 mg, Ecopipam 89.6 mg, Ecopipam 33.6 mg, Ecopipam 22.4 mg, Ecopipam 44.8 mg, Ecopipam 67.2 mg

Primary endpoint: There are not any endpoints for the study since it is an Open Label study

Source: https://euclinicaltrials.eu/ctis-public/view/2023-503545-67-00